EU clinical trial 2023-508798-94-00: BONFIRE - Beta-blockers discontinuation in patients presenting heart failure with recovered left ventricular ejection fraction
Protocol code: APHP230833
Sponsor: Assistance Publique Hopitaux De Paris (Hospital/Clinic/Other health care facility). Phase: Therapeutic confirmatory (Phase III). Countries: France (ongoing, recruiting).
Therapeutic area(s): Diseases [C] - Cardiovascular Diseases [C14]
Gender: Female, Male. Age: 18-64 years, 65+ years. Enrolment: 1300.
Status: Ongoing, recruiting. Start date (EU): 2025-02-11. Decision date: 2024-06-12. Results received: No. Last updated: 2026-04-07.

Condition(s): Heart failure
Product: VALSARTAN AND SACUBITRIL, CARVEDILOL, DAPAGLIFLOZIN, RAMIPRIL, LOSARTAN

Primary endpoint: The primary endpoint will be evaluated during the follow-up of the patients (1-year minimum follow-up , 4–year-maximum follow-up) and will be the first occurrence of one of the event of the composite endpoint : 1/ HF relapse (at any time during the study): drop in LVEF >10% (expressed as absolute value), relative increase in body surface area-indexed LVEDVi >10%, increase in NT-proBNP >2x and ≥400 ng/L, worsening HF symptoms requiring hospitalization or urgent visits or out-of-hospital therapeut
Endpoint(s): HF relapse defined by 1/ Reduction in LVEF by more than 10% (absolute value) 2/ A relative increase in LVEDVi by more than 10% 3/ A two-fold rise in baseline NT-pro-BNP concentration and to more than 400 ng/L. 4/ Clinical evidence of heart failure, based on signs and symptoms as adjudicated by the research team. 5/Hospitalization for worsening HF, All-cause Death, All individual reasons for Hospitalisation, as follows: 1/ ACS or need for coronary catheterisation +/- revascularization ; 2/ Recurrent ischemia ; 3/ Supra-ventricular or ventricular arrhythmias ; 4/ Syncope, PM implantation ; 5/ High blood pressure ; 6/ Stroke, All-cause cardiovascular death, Additional analyses of HF relapse: Number of patients with reduction in LVEF by more than 10% (absolute value) and to less than 50%., Additional analyses of HF relapse: Number of patients with a relative increase in LVEDVi by more than 10% and to higher than the normal range, Additional analyses of HF relapse: Number of patients hospitalized for worsening HF, Number of patients needing loop diuretics for congestive symptoms, during hospitalization and/or in out-of-hospital settings, Changes in NYHA Class, Absolute values of NT-pro-BNP concentrations at the different visits, Proportion of patients with changes in NT-proBNP concentrations to more than 400 ng/L, Number of patients needing beta-blocker re-introduction in the experimental group or beta-blocker discontinuation in the control group, Occurrence of arrhythmic events (any types, i.e., supra-ventricular and/or ventricular arrhythmias & requiring hospitalization or not) in all participants, Occurrence of infra-clinic supra-ventricular and/or ventricular arrhythmias in patients implanted with ICD before participating the study, Quality of life (QoL) evaluated by the auto-questionnaire (EQ5D), Quality of life with heart failure, evaluated by the auto-questionnaire KCCQ-12 filled by the patients himself, Anxiety: questionnaire HADS (Hospital Anxiety and Depression Scale), Evaluation of Side effects: Absolute values of heart rate at the different visits and relative change as compared to baseline values (first year), Evaluation of Side effects: Questionnaire on the Presence of Blury Vision, Evaluation of Side effects: Sensation of cold hands and feet, Evaluation of Side effects: Insomnia, Occurrence of Palpitations, Syncope / Dizziness requiring a consultation, Evaluation of compliance to therapies by self-questionnaire, Exercice capacity by 6M walk test (in participating centers)

Source: https://euclinicaltrials.eu/ctis-public/view/2023-508798-94-00